EU clinical trial 2023-507363-20-00: A Phase 1, Randomized, Double-Blind, Placebo-Controlled, Dose-Escalating Study to Evaluate the Safety, Tolerability, and Pharmacokinetics of Single Ascending and Multiple Ascending Doses of Prosetin in Healthy Volunteers and Participants with Amyotrophic Lateral Sclerosis (ALS) with an Optional Open-Label Extended Treatment Period for ALS Participants who Complete 14 Days of Blinded Treatment
Protocol code: PRO-101
Sponsor: Projenx Inc. (Pharmaceutical company). Phase: Human Pharmacology (Phase I)- First administration to humans. Countries: Netherlands (ongoing, recruitment ended).
Therapeutic area(s): Diseases [C] - Nervous System Diseases [C10]
Gender: Female, Male. Age: 18-64 years, 65+ years. Enrolment: 14.
Status: Ongoing, recruitment ended. Start date (EU): 2024-07-12. Decision date: 2024-02-05. Results received: No. Last updated: 2026-02-19.

Condition(s): Amyotrophic lateral sclerosis (ALS)

Source: https://euclinicaltrials.eu/ctis-public/view/2023-507363-20-00